EU clinical trial 2025-521865-29-00: A Phase 2, randomized, placebo-controlled, double-blind clinical study to evaluate efficacy and safety of LAD328 in adult subjects with moderate to severe hidradenitis suppurativa
Protocol code: M-00401-10
Sponsor: Almirall S.A. (Pharmaceutical company). Phase: Therapeutic exploratory (Phase II). Countries: Bulgaria (ongoing, recruiting), Spain (ongoing, recruiting), France (ongoing, recruiting), Poland (ongoing, recruiting), Germany (authorised, recruiting).
Therapeutic area(s): Diseases [C] - Skin and Connective Tissue Diseases [C17]
Gender: Female, Male. Age: 18-64 years. Enrolment: 4999995.
Start date (EU): 2026-04-30. Decision date: 2026-04-01. Results received: No. Last updated: 2026-04-09.
Decision dates by country: FR: 2026-04-09, BG: 2026-04-01, PL: 2026-04-09, ES: 2026-04-01, DE: 2026-04-09

Condition(s): moderate-to-severe hidradenitis suppurativa
Product: LAD328, SODIUM CHLORIDE

Primary endpoint: Proportion of participants achieving IHS4-55 at XXXX., Safety: Frequency and severity of TEAEs, SAEs, AESIs and AEs leading to discontinuation., Safety: Vital signs, ECG and clinical laboratory parameters.

Source: https://euclinicaltrials.eu/ctis-public/view/2025-521865-29-00